EU clinical trial 2024-518103-21-00: A study in healthy men to compare the amount of vicadrostat and empagliflozin in the blood when taken separately and together
Protocol code: 1378-0024
Sponsor: Boehringer Ingelheim International GmbH (Pharmaceutical company). Phase: Human Pharmacology (Phase I)- Other. Countries: Germany (ended).
Therapeutic area(s): Not possible to specify
Gender: Male. Age: 18-64 years. Enrolment: 15.
Status: Ended. Start date (EU): 2025-06-30. End date (EU): 2025-08-15. Decision date: 2025-06-16. Results received: No. Last updated: 2025-06-16.

Condition(s): Healthy volunteer trial

Source: https://euclinicaltrials.eu/ctis-public/view/2024-518103-21-00